EU clinical trial 2023-510464-12-00: A study in healthy men to test how BI 1569912 is processed in the body
Protocol code: 1447-0010
Sponsor: Boehringer Ingelheim International GmbH (Pharmaceutical company). Phase: Human Pharmacology (Phase I)- Other. Countries: Netherlands (ended).
Therapeutic area(s): Not possible to specify
Gender: Male. Age: 18-64 years. Enrolment: 8.
Status: Ended. Start date (EU): 2024-08-26. End date (EU): 2024-10-03. Decision date: 2024-08-20. Results received: No. Last updated: 2024-08-20.

Condition(s): Healthy volunteer trial

Source: https://euclinicaltrials.eu/ctis-public/view/2023-510464-12-00